EU clinical trial 2024-516840-24-00: A Phase 1, Randomized, Double-Blind, Placebo-Controlled, Multi-Centre Study to Assess the Safety, Tolerability, and Pharmacodynamics of AZD4144 in Participants with Established Atherosclerotic Cardiovascular and Chronic Kidney Disease
Protocol code: D9441C00001
Sponsor: AstraZeneca AB (Pharmaceutical company). Phase: Human Pharmacology (Phase I)- Other. Countries: Bulgaria (ended), Romania (ended), Hungary (ended).
Therapeutic area(s): Diseases [C] - Cardiovascular Diseases [C14]
Gender: Female, Male. Age: 18-64 years, 65+ years. Enrolment: 36.
Status: Ended. Start date (EU): 2025-03-05. End date (EU): 2025-10-27. End date: 2025-10-28. Decision date: 2025-02-13. Results received: No. Last updated: 2025-12-16.
Decision dates by country: HU: 2025-02-13, RO: 2025-02-14, BG: 2025-02-17

Condition(s): Chronic Kidney disease, Atherosclerotic Cardiovascular Disease

Source: https://euclinicaltrials.eu/ctis-public/view/2024-516840-24-00